EU clinical trial 2025-524446-10-00: Phase 1 open label trial of MST-0312 alone and in combination in subjects with solid malignancies
Protocol code: MST-0312-1001
Sponsor: Mestag Therapeutics Limited (Pharmaceutical company). Phase: Human Pharmacology (Phase I)- First administration to humans. Countries: Spain (ongoing, recruiting).
Therapeutic area(s): Diseases [C] - Neoplasms [C04]
Gender: Female, Male. Age: 18-64 years, 65+ years. Enrolment: 42.
Status: Ongoing, recruiting. Start date (EU): 2026-04-01. Decision date: 2026-03-13. Results received: No. Last updated: 2026-07-30.

Condition(s): Solid Malignancies

Source: https://euclinicaltrials.eu/ctis-public/view/2025-524446-10-00